EU clinical trial 2025-523948-12-00: Bioequivalence of Cinnarizine/Dimenhydrinate 20 mg/40 mg Tablets in Healthy Participants Under Fed Conditions.
Protocol code: BLCL-CID-EU-01
Sponsor: Hennig Arzneimittel GmbH & Co. KG (Pharmaceutical company). Phase: Human Pharmacology (Phase I)- Bioequivalence Study. Countries: Portugal (ended).
Therapeutic area(s): Not possible to specify
Gender: Female, Male. Age: 18-64 years. Enrolment: 38.
Status: Ended. Start date (EU): 2025-11-27. End date (EU): 2026-02-07. Decision date: 2025-11-04. Results received: No. Last updated: 2026-01-21.

Condition(s): No medical condition.

Source: https://euclinicaltrials.eu/ctis-public/view/2025-523948-12-00